EU clinical trial 2024-520090-12-00: Dual-Wavelength Quantitative Fluorescence Endoscopy for Optical PD-1 and PD-L1 Imaging in Locally Advanced Esophageal Cancer: A Phase I Multicenter Feasibility and Safety Study
Sponsor: Universitair Medisch Centrum Groningen (Hospital/Clinic/Other health care facility). Phase: Human Pharmacology (Phase I)- First administration to humans. Countries: Netherlands (ongoing, recruiting).
Therapeutic area(s): Diseases [C] - Digestive System Diseases [C06]; Diseases [C] - Neoplasms [C04]
Gender: Female, Male. Age: 18-64 years, 65+ years. Enrolment: 15.
Status: Ongoing, recruiting. Start date (EU): 2026-05-01. Decision date: 2025-06-13. Results received: No. Last updated: 2026-02-26.

Condition(s): Esophageal cancer

Source: https://euclinicaltrials.eu/ctis-public/view/2024-520090-12-00